EU clinical trial 2025-521185-10-00: The effect of systemic antibiotics on post-surgical complications and patient-centered outomes in patients undergoing implant surgery with the guided bone regeneration and simultaneous sinus floor elevation.
Sponsor: Complutense University Of Madrid (Educational Institution). Phase: Therapeutic use (Phase IV). Countries: Spain (ongoing, recruiting).
Therapeutic area(s): Analytical, Diagnostic and Therapeutic Techniques and Equipment [E] - Dentistry [E06]
Gender: Female, Male. Age: 18-64 years, 65+ years. Enrolment: 30.
Status: Ongoing, recruiting. Start date (EU): 2025-04-09. Decision date: 2025-03-18. Results received: No. Last updated: 2025-04-09.

Condition(s): The medical condition that the patients have in this trial is edentulism in a posterior maxillary quadrant of the mouth with a sinus pneumatisation/ decreased crestal bone heigh defect requiring augmentation and rehabilitation with 1-3 implants. We want to investigate the effect of amoxicillin after this procedure in terms of complications and patient-centered outcomes.
Product: AMOXICILINA NORMON 500 mg Cápsulas duras EFG, Cornstarch (Asylum Maydis)

Primary endpoint: Patient Reported Outcome Measures (PROMs): Visual analogue scores VAS on the wound (pain, swelling, bruising (haematoma), bleeding) and discomfort of the sinuses (nosebleed, nasal congestion, rhinorrhea (excessive nasal discharge including posterior nasal drip), feeling of pressure, hyposmia (reduction in smell)
Endpoint(s): Clinical recordings of post-surgical complications: flap closure/dehiscence, purulent discharge, swelling and implant stability and early implant loss.

Source: https://euclinicaltrials.eu/ctis-public/view/2025-521185-10-00